EU clinical trial 2023-508085-15-00: A double-blinded extension study to evaluate the long-term safety and tolerability of itepekimab in patients with chronic obstructive pulmonary disease (COPD) who participated in either EFC16750 or EFC16819 clinical studies
Protocol code: LTS18133
Sponsor: Sanofi-Aventis Recherche & Developpement (Pharmaceutical company). Phase: Therapeutic confirmatory (Phase III). Countries: Denmark (ended), Latvia (ended), Portugal (ongoing, recruitment ended), Poland (ongoing, recruitment ended), Germany (ongoing, recruitment ended), Romania (ongoing, recruitment ended), Greece (ended), France (ongoing, recruitment ended), Netherlands (ended), Estonia (ended), Norway (ended), Hungary (ongoing, recruitment ended), Bulgaria (ongoing, recruitment ended), Czechia (ongoing, recruitment ended), Italy (ended), Slovakia (ongoing, recruitment ended), Spain (ongoing, recruitment ended), Lithuania (ended).
Therapeutic area(s): Diseases [C] - Respiratory Tract Diseases [C08]
Gender: Female, Male. Age: 18-64 years, 65+ years. Enrolment: 247.
Start date (EU): 2024-05-15. Decision date: 2024-04-29. Results received: No. Last updated: 2026-08-04.
Decision dates by country: BG: 2024-05-02, DK: 2024-04-29, EE: 2024-04-30, IT: 2024-05-02, LV: 2024-04-30, LT: 2024-04-30, PT: 2024-04-29, NL: 2024-04-29, NO: 2024-04-30, PL: 2024-05-02, RO: 2024-04-30, GR: 2024-05-02, HU: 2024-05-01, CZ: 2024-05-02, SK: 2024-04-30, FR: 2024-05-02, ES: 2024-04-29, DE: 2024-05-02

Condition(s): Chronic Obstructive Pulmonary Disease
Product: Matched Placebo for test product, Itepekimab

Primary endpoint: Incidence of treatment‑emergent AEs, AESIs, SAEs, and AEs leading to permanent treatment discontinuation
Endpoint(s): Functional itepekimab concentrations in serum, Incidence of treatment emergent (TE) anti-drug antibody responses, Annualized rate of moderate to severe acute exacerbation of COPD (AECOPD), Annualized rate of severe AECOPD, Time to first moderate-to-severe AECOPD, Time to first severe AECOPD, Change from baseline of the parent studies (EFC16750, EFC16819): Pre-BD and post-BD FEV1, Change from baseline of the parent studies (EFC16750, EFC16819): SGRQ total score and domain scores, Change from baseline of the parent studies (EFC16750, EFC16819): EQ-5D-5L single index score, Change from baseline of the parent studies (EFC16750, EFC16819): EQ-VAS, Change from Week 0 for CASA-Q

Source: https://euclinicaltrials.eu/ctis-public/view/2023-508085-15-00